EU clinical trial 2022-502843-36-00: A Phase 0 Open Label Positron Emission Tomography Study to Assess the Biodistribution and Binding Characteristics of [11C]AZ14132516 Following Administration to Healthy Participants
Protocol code: D9690C00003
Sponsor: AstraZeneca AB (Pharmaceutical company). Phase: Human Pharmacology (Phase I)- First administration to humans. Countries: Sweden (ended).
Therapeutic area(s): Analytical, Diagnostic and Therapeutic Techniques and Equipment [E] - Investigative Techniques [E05]
Gender: Female, Male. Age: 18-64 years. Enrolment: 9.
Status: Ended. Start date (EU): 2023-04-27. End date (EU): 2023-07-11. Decision date: 2023-04-03. Results received: Yes. Last updated: 2023-04-03.

Condition(s): Crohn's disease

Primary endpoint: Standard uptake value (SUV) in region of interest; Standard uptake value ratio (SUVR) in regions of interest (ie, total binding of [11C]AZ14132516 to CCR9)
Endpoint(s): Absolute percentage differences of total binding of [11C]AZ14132516 to CCR9 in regions of interest between two PET examinations, Intraclass correlation coefficients, Description of any safety findings, AEs

Source: https://euclinicaltrials.eu/ctis-public/view/2022-502843-36-00